EU clinical trial 2023-505221-14-00: A Phase 2, Multi-cohort Study Applying Innovative MRD Techniques for Transplant Eligible Participants with Previously Untreated Multiple Myeloma - TAURUS
Protocol code: EMN33
Sponsor: European Myeloma Network B.V., Emn Trial Office S.r.l. Impresa Sociale (Patient organisation/association, Laboratory/Research/Testing facility). Phase: Therapeutic exploratory (Phase II). Countries: Italy (ongoing, recruiting), Greece (ongoing, recruiting), Austria (ongoing, recruiting), Netherlands (ongoing, recruiting), Germany (ongoing, recruiting).
Therapeutic area(s): Diseases [C] - Neoplasms [C04]
Gender: Female, Male. Age: 18-64 years, 65+ years. Enrolment: 237.
Status: Ongoing, recruiting. Start date (EU): 2024-04-04. Decision date: 2023-11-07. Results received: No. Last updated: 2026-02-19.
Decision dates by country: NL: 2023-11-09, DE: 2023-11-13, AT: 2023-11-13, IT: 2023-11-07, GR: 2023-11-08

Condition(s): Multiple Myeloma, Multiple Myeloma
Product: JNJ-79635322, DEXAMETHASONE SODIUM PHOSPHATE, DEXAMETHASONE, Lenalidomide Accord 15 mg hard capsules, DEXAMETHASONE, DIPHENHYDRAMINE, VELCADE 3.5 mg powder for solution for injection, JNJ-79635322, Lenalidomide Accord 5 mg hard capsules, teclistamab, DEXAMETHASONE, Lenalidomide Accord 10 mg hard capsules, Lenalidomide Accord 25 mg hard capsules, DEXAMETHASONE, PARACETAMOL, DARZALEX 1800 mg solution for injection, DEXAMETHASONE SODIUM PHOSPHATE, DEXAMETHASONE, DEXAMETHASONE, Lenalidomide Accord 20 mg hard capsules, JNJ-64407564, teclistamab, JNJ-64407564

Primary endpoint: The primary and secondary endpoints, and their respective timepoints are defined in Table 33 of the Protocol
Endpoint(s): The primary and secondary endpoints, and their respective timepoints are defined in Table 33 of the Protocol, Incidence and severity of AEs, adverse laboratory results, and other safety parameters following TEC-TAL, JNJ-79635322-D, and JNJ-79635322-DR administration.

Source: https://euclinicaltrials.eu/ctis-public/view/2023-505221-14-00